EU clinical trial 2024-517667-23-00: A randomized controlled phase II, double blinded trial to investigate pulmonary function after treatment with rituximab compared to placebo in patients with Granulomatous Lymphocytic Interstitial Lung Disease
Protocol code: GRIT
Sponsor: Oslo University Hospital HF (Hospital/Clinic/Other health care facility). Phase: Therapeutic exploratory (Phase II). Countries: Norway (ongoing, recruiting), Denmark (authorised, recruitment pending), Sweden (authorised, recruitment pending), Finland (authorised, recruitment pending).
Therapeutic area(s): Diseases [C] - Immune System Diseases [C20]
Gender: Female, Male. Age: 18-64 years, 65+ years. Enrolment: 40.
Start date (EU): 2025-12-17. Decision date: 2025-06-09. Results received: No. Last updated: 2025-12-02.
Decision dates by country: DK: 2025-06-10, NO: 2025-06-09, FI: 2025-06-09, SE: 2025-06-09

Condition(s): Granulomatous Lymphocytic Interstitial Lung Disease (GLILD)
Product: Natriumklorid Baxter Viaflo 9 mg/ml infusjonsvæske, oppløsning, MabThera 500 mg concentrate for solution for infusion

Primary endpoint: DLCO (expressed in p.p. of predicted DLCO value) at Week 27 (continuous).
Endpoint(s): DLCO (expressed in p.p. of predicted DLCO value) at baseline, Week 13, 53 and 78 (continuous)., Reaching a 10 p.p. increase in % of predicted DLCO from baseline to Week 27 (dichotomous)., FVC (expressed in p.p. of predicted FVC value) at Week 13, 27, 53 and 78 (continuous)., Reaching a 5 p.p. increase in % of predicted FVC from baseline to Week 27 (dichotomous)., HRCT ILD score at baseline, Week 27 and 53 (continuous)., King’s Brief Interstitial Lung Disease (K-BILD) Questionnaire scores (total and per domain) at baseline and Week 27 (continuous)., Short Form 36 Health Survey (SF-36) scores (total and per domain/concept) at baseline and Week 27 (continuous)., Serum levels of sCD25, sTIM3, BAFF and sBCMA at baseline, Week 13, 27 and 53 (continuous).

Source: https://euclinicaltrials.eu/ctis-public/view/2024-517667-23-00